EU clinical trial 2023-505082-91-00: Open-label, single-arm, non-controlled trial to evaluate the safety and tolerability of treprostinil sodium in children below the age of 18 with pulmonary arterial hypertension (PAH)
Protocol code: TREPaed
Sponsor: Aop Orphan Pharmaceuticals GmbH (Pharmaceutical company). Phase: Therapeutic confirmatory (Phase III). Countries: Austria (ongoing, recruiting), Spain (ongoing, recruiting), France (ongoing, recruiting), Hungary (ongoing, recruiting), Slovakia (ongoing, recruiting), Germany (ongoing, recruiting).
Therapeutic area(s): Diseases [C] - Respiratory Tract Diseases [C08]
Gender: Female, Male. Age: 0-17 years. Enrolment: 37.
Status: Ongoing, recruiting. Start date (EU): 2024-05-29. Decision date: 2024-02-08. Results received: No. Last updated: 2026-06-14.
Decision dates by country: AT: 2024-02-12, FR: 2024-05-07, ES: 2024-04-30, SK: 2024-10-28, DE: 2025-10-28, HU: 2024-05-22

Condition(s): Pulmonary Arterial Hypertension (PAH)
Product: TREPaed_2.5, TREPaed_10, TREPaed_0.5, TREPaed_5, TREPaed_1

Primary endpoint: The frequency and seriousness of adverse events and adverse drug reactions during the first 5 months (20 weeks ± 1 weeks) of treatment according to Common Terminology Criteria for Adverse Events (CTCAE, version 5.0).
Endpoint(s): Change from baseline in quality of Life (QoL) as assessed by the Pediatric Quality of Life Inventory (PedsQoL Version 4.0) questionnaire., Change from baseline in 6MWD (patients > 6 years), Change from baseline in WHO FC, Change from baseline in echocardiography (ECHO) parameters, Change from baseline in plasma N-terminal pro-brain natriuretic peptide (NTproBNP), The frequency and seriousness of adverse events and adverse drug reactions according to Common Terminology Criteria for Adverse Events (CTCAE, version 5.0) during the observational period, Treprostinil plasma concentration

Source: https://euclinicaltrials.eu/ctis-public/view/2023-505082-91-00